EU clinical trial 2024-518652-23-00: Long-term safety study of personalized cholic acid treatment in patients with bile acid synthesis defects
Sponsor: Amsterdam UMC Stichting (Patient organisation/association). Phase: Phase III and phase IV (Integrated). Countries: Netherlands (ended).
Therapeutic area(s): Diseases [C] - Nutritional and Metabolic Diseases [C18]
Gender: Female, Male. Age: 0-17 years, 18-64 years, 65+ years. Enrolment: 8.
Status: Ended. End date (EU): 2025-03-17. Decision date: 2024-11-25. Results received: No. Last updated: 2024-11-25.

Condition(s): Bile acid synthesis defects
Product: CHOLIC ACID

Primary endpoint: Degree of suppression of endogenous bile acid synthesis (decrease in serum [and urine] DHCA and THCA bile acid intermediates), Type and number of adverse events, Type and number of side effects
Endpoint(s): Increase in normal primary bile acids (increase in urine cholic acid [CA]), Change in serum ALT, AST, transaminases, γ-glutamyltrans- peptidase, conjugated bilirubin, total bilirubin levels, gamma-GT, alkaline phosphatase, alpha-1-phetoprotein, Change in liver protein synthesis (determined by albumin, pre-albumin and prothrombin time [PT]), Change in degree of coagulopathy (measured by PT, aPTT, Factor V and Factor VII), Change in weight gain (weight-for-height percentile), Change total body length growth rate (cm/year; only in those with remaining growth potential), Change in fat soluble vitamins (A,D, E) level and total cholesterol, Development of fibrosis/cirrhosis (determined by fibroscan or US elastography), Neurological development

Source: https://euclinicaltrials.eu/ctis-public/view/2024-518652-23-00